EU clinical trial 2024-519978-39-00: Autologous tolerogenic dendritic cells (ATDC) for highly sensitized kidney transplant recipients
Protocol code: ATDC-PICI
Sponsor: Fundacio De Recerca Clinic Barcelona-Institut D’Investigacions Biomediques August Pi I Sunyer (Laboratory/Research/Testing facility). Phase: Human Pharmacology (Phase I)- Other. Countries: Spain (ongoing, recruitment ended).
Therapeutic area(s): Phenomena and Processes [G] - Reproductive and Urinary Physiological Phenomena [G08]
Gender: Female, Male. Age: 18-64 years. Enrolment: 30.
Status: Ongoing, recruitment ended. Start date (EU): 2026-04-17. Decision date: 2025-05-16. Results received: No. Last updated: 2026-04-16.

Condition(s): Kidney trasplants

Source: https://euclinicaltrials.eu/ctis-public/view/2024-519978-39-00